EU clinical trial 2022-502145-10-00: A Phase 3, Open-Label, Randomized, Two-Part Study Comparing Gedatolisib in Combination with Palbociclib and Fulvestrant to Standard-of-Care Therapies in Patients with HR-Positive, HER2-Negative Advanced Breast Cancer Previously Treated with a CDK4/6 Inhibitor in Combination with Non-Steroidal Aromatase Inhibitor Therapy (VIKTORIA-1)
Protocol code: CELC-G-301
Sponsor: Celcuity Inc. (Pharmaceutical company). Phase: Therapeutic confirmatory (Phase III). Countries: Poland (ongoing, recruitment ended), Czechia (ongoing, recruitment ended), Romania (ongoing, recruitment ended), Austria (ongoing, recruitment ended), Belgium (ongoing, recruitment ended), France (ongoing, recruitment ended), Italy (ongoing, recruitment ended), Bulgaria (ongoing, recruitment ended), Hungary (ongoing, recruitment ended), Germany (ongoing, recruitment ended), Greece (ongoing, recruitment ended), Spain (ongoing, recruitment ended).
Therapeutic area(s): Diseases [C] - Hormonal diseases [C19]
Gender: Female, Male. Age: 18-64 years, 65+ years. Enrolment: 233.
Status: Ongoing, recruitment ended. Start date (EU): 2023-06-06. Decision date: 2023-05-02. Results received: No. Last updated: 2026-08-07.
Decision dates by country: IT: 2023-05-05, BE: 2023-05-02, GR: 2023-05-03, BG: 2023-05-09, DE: 2023-05-08, RO: 2023-05-08, CZ: 2023-05-04, PL: 2023-05-08, ES: 2023-05-08, FR: 2023-05-09, AT: 2023-05-08, HU: 2023-05-04

Condition(s): Hormone Receptor (HR)-Positive, Human Epidermal Growth Factor Receptor 2 (HER2)-Negative Advanced Breast Cancer Previously Treated with a CDK4/6 Inhibitor in Combination with Non-Steroidal Aromatase Inhibitor Therapy
Product: IBRANCE 100 mg film-coated tablets, Piqray 150 mg film-coated tablets, Gedatolisib, Dexamethasone, IBRANCE 125 mg film-coated tablets, Piqray 50 mg and 200 mg film-coated tablets, IBRANCE 75 mg film-coated tablets, Piqray 200 mg film-coated tablets, Fulvestrant EVER Pharma 250 mg Injektionslösung in einer Fertigspritze

Primary endpoint: Study 1 & Study 2: Overall progression-free survival (PFS) curves using the Kaplan-Meier (KM) method, where PFS is defined as the time from randomization to death or the first documented radiological disease progression, whichever occurs first, confirmed by Response Evaluation Criteria in Solid Tumors (RECIST) v1.1 criteria, as determined based on blinded independent central review (BICR)

Source: https://euclinicaltrials.eu/ctis-public/view/2022-502145-10-00